EU clinical trial 2024-515317-18-00: Tolerance of intra-articular injection of autologous stromal vascular fraction for the treatment of rhizarthrosis_FVS-RHIZA
Protocol code: 2018/0419/HP
Sponsor: Centre Hospitalier Universitaire Rouen (Hospital/Clinic/Other health care facility). Phase: Therapeutic exploratory (Phase II). Countries: France (ongoing, recruiting).
Therapeutic area(s): Diseases [C] - Musculoskeletal Diseases [C05]
Gender: Female, Male. Age: 18-64 years, 65+ years. Enrolment: 10.
Status: Ongoing, recruiting. Start date (EU): 2023-10-26. Decision date: 2024-09-24. Results received: No. Last updated: 2026-06-09.

Condition(s): Adults with a rhizarthrosis stage DELL 1 to 3
Product: AUTOLOGOUS ADIPOSE TISSUE-DERIVED STROMAL VASCULAR FRACTION 5 MILLIONS CELLS

Primary endpoint: The number of treatment-attributable Grade ≥ 3 adverse reactions occurring over a 6-month period after intra-articular injection of FVS
Endpoint(s): Assess at 1, 3 and 6 months functional assessment of the hand (Kapandji score, JAMAR and Key pinch, Active mobility of the trapezio-metacarpal in antepulsion and abduction, Grinding test, DASH and PWRHE quick score), Assess at 1, 3 and 6 months the pain by the EVA scale and by monitoring the progress of long-term analgesic treatment, Assess at 1, 3 and 6 months cartilage regeneration (Evaluation by MRI of the cartilage and X-ray of the trapezio-metacarpal, Assessment of adverse events using EvI/EvIG data collection

Source: https://euclinicaltrials.eu/ctis-public/view/2024-515317-18-00